EU clinical trial 2024-513363-15-01: CLEAR-PATH A randomized placebo-controlled double-blind trial studying the effect of single antiplatelet therapy (clopidogrel) versus dual antiplatelet therapy (clopidogrel/acetylsalicylic acid) on the occurrence of atherothrombotic events following lower extremity peripheral transluminal angioplasty
Sponsor: Universitair Medisch Centrum Utrecht (Hospital/Clinic/Other health care facility). Phase: Phase III and phase IV (Integrated). Countries: Netherlands (ongoing, recruiting).
Therapeutic area(s): Diseases [C] - Cardiovascular Diseases [C14]
Gender: Female, Male. Age: 18-64 years, 65+ years. Enrolment: 1696.
Status: Ongoing, recruiting. Start date (EU): 2024-07-22. Decision date: 2024-07-22. Results received: No. Last updated: 2025-08-14.

Condition(s): (Chronic) Peripheral (occlusive) arterial disease (PAD)
Product: LACTOSE MONOHYDRATE, Clopidogrel Viatris 75 mg film coated tablets, Acetylsalicylzuur Aurobindo cardio 80 mg, tabletten., Clopidogrel Zentiva 75 mg film-coated tablets

Primary endpoint: The primary endpoint is all-cause death and the occurence of cardiovascular adverse events after 1 year: (indication for) re-intervention due to any restenosis or re-occlusion or due to acute limb ischemia, the occurence of any amputation, cerebrovascular event, myocardial infarction, or cardiovascular death.
Endpoint(s): The secondary endpoint is the occurence of all and major bleeding (following the TIMI bleeding classification and BARC criteria), major adverse cardiovascular events (MACE), and major adverse limb events (MALE). CYP2C19 polymorphisms will be determined to examine if non-responsiveness to clopidogrel predicts outcome.

Source: https://euclinicaltrials.eu/ctis-public/view/2024-513363-15-01